EU clinical trial 2024-516219-25-00: A Phase 3, parallel-group, randomized, double-blind, 4-arm, placebo-controlled, multicenter study with risankizumab as active reference arm, to investigate the efficacy and safety of subcutaneous sonelokimab in male and female participants aged 18 years and over with active psoriatic arthritis and previous inadequate response or intolerance to tumor necrosis factor-α inhibitors
Protocol code: M1095-PSA-302
Sponsor: MoonLake Immunotherapeutics AG (Pharmaceutical company). Phase: Therapeutic confirmatory (Phase III). Countries: Spain (ongoing, recruiting), Czechia (ongoing, recruiting), Bulgaria (ongoing, recruiting), Poland (ongoing, recruiting), Hungary (ongoing, recruiting), France (authorised, recruiting), Germany (ongoing, recruiting).
Therapeutic area(s): Diseases [C] - Skin and Connective Tissue Diseases [C17]; Diseases [C] - Musculoskeletal Diseases [C05]
Gender: Female, Male. Age: 18-64 years, 65+ years. Enrolment: 372.
Start date (EU): 2025-03-25. Decision date: 2025-03-07. Results received: No. Last updated: 2026-06-10.
Decision dates by country: BG: 2025-03-12, PL: 2025-03-16, HU: 2025-03-13, ES: 2025-03-10, FR: 2025-03-07, CZ: 2025-03-11, DE: 2025-03-10

Condition(s): psoriatic arthritis
Product: Skyrizi 150 mg solution for injection in pre-filled syringe, Sonelokimab, Sonelokimab, Placebo is a sterile solution in a single use prefilled syringe (PFS) intended for subcutaneous administration.

Primary endpoint: 1. Proportion of participants achieving ACR50 (ie, ≥50% response on the ACR response criteria) at Week 16
Endpoint(s): 1. Proportion of participants achieving ACR20 (ie, ≥20% response on the ACR response criteria) at Week 16, 2. Proportion of participants achieving Minimal Disease Activity (MDA) at Week 16, 3. Change from Baseline in Health Assessment Questionnaire—Disability Index (HAQ-DI) at Week 16, 4. Proportion of participants achieving PASI90 response at Week 16 in the subset of participants with PsO involving ≥3% body surface area at Baseline, 5. Change from Baseline in SF-36 PCS at Week 16, 6. Proportion of participants achieving ACR50 at Week 16, 7. Incidence, relatedness, severity, and seriousness of TEAEs, 8. Withdrawal due to TEAEs, 9. Clinically relevant abnormalities in vital signs (blood pressure and heart rate) and body weight, 10. Clinically relevant abnormalities in 12-lead ECG variables, 11. Clinically relevant abnormalities in laboratory parameters (hematology, biochemistry, and urinalysis)

Source: https://euclinicaltrials.eu/ctis-public/view/2024-516219-25-00